EU clinical trial 2024-514974-39-00: A Phase 3, Open-Label Study to Investigate the Long-Term Safety and Efficacy of LP352 in the Treatment of Seizures in Children and Adults with Developmental and Epileptic Encephalopathy
Protocol code: LP352-303
Sponsor: Longboard Pharmaceuticals Inc. (Pharmaceutical company). Phase: Therapeutic confirmatory (Phase III). Countries: Netherlands (authorised, recruitment pending), Latvia (ongoing, recruiting), Italy (ongoing, recruiting), France (ongoing, recruiting), Portugal (ongoing, recruiting), Belgium (ongoing, recruiting), Germany (ongoing, recruiting), Spain (ongoing, recruiting).
Therapeutic area(s): Diseases [C] - Nervous System Diseases [C10]
Gender: Female, Male. Age: 0-17 years, 18-64 years, 65+ years. Enrolment: 181.
Start date (EU): 2025-10-10. Decision date: 2025-06-17. Results received: No. Last updated: 2026-06-29.
Decision dates by country: FR: 2025-08-07, LV: 2025-06-18, ES: 2025-06-26, DE: 2025-08-06, BE: 2025-06-17, PT: 2025-06-23, IT: 2025-06-23, NL: 2025-06-18

Condition(s): Developmental and Epileptic Encephalopathies (DEEs)
Product: LP352 (bexicaserin) Placebo Oral Solution, Bexicaserin

Primary endpoint: 1. Incidence and severity of TEAEs, including SAEs and AEs leading to discontinuation, 2. Changes in safety laboratory parameters, 3. Physical examination findings, 4. Vital signs, 5. ECGs, and growth parameters (height and weight), 6. Changes in suicidality or depression as rated by C-SSRS and PHQ-9 responses, 7. Changes in puberty development as rated by Tanner Staging
Endpoint(s): 1. Frequency percent change in countable motor seizures during Treatment (28-day average) compared to Baseline (28-day average) as assessed by seizure eDiary, 2. 50% responder rate (the percentage of participants with a ≥50% reduction in countable motor seizures) during Treatment (28-day average) compared to Baseline (28-day average) as assessed by seizure eDiary, 3. Frequency percent change in countable motor seizures during Maintenance (28-day average) compared to Baseline (28-day average) as assessed by seizure eDiary, 4. 50% responder rate (the percentage of participants with a ≥50% reduction in countable motor seizures) during Maintenance (28-day average) compared to Baseline (28-day average) as assessed by seizure eDiary

Source: https://euclinicaltrials.eu/ctis-public/view/2024-514974-39-00